EU clinical trial 2022-501682-45-00: The effect of empagliflozin on peripheral microvascular dysfunction in heart failure with preserved ejection fraction
Sponsor: University Hospital Maastricht (Hospital/Clinic/Other health care facility). Phase: Therapeutic use (Phase IV). Countries: Netherlands (ended).
Therapeutic area(s): Diseases [C] - Cardiovascular Diseases [C14]
Gender: Female, Male. Age: 18-64 years, 65+ years. Enrolment: 48.
Status: Ended. Start date (EU): 2023-02-13. End date (EU): 2024-12-01. Decision date: 2022-11-22. Results received: Yes. Last updated: 2022-12-01.
Decision dates by country: NL: 2022-12-01

Condition(s): Heart failure with preserved ejection fraction
Product: Miochol®-E 10 mg/ml Pulver und Lösungsmittel zur Herstellung einer Instillationslösung zur intraokularen Anwendung, NIPRUSS 60 mg, poeder voor oplossing voor infusie, NovoRapid 100 units/ml solution for injection in vial, Jardiance 10 mg film-coated tablets

Primary endpoint: Cutaneous vascular conductance (CVC) (Skin blood flow divided by the mean arterial pressure) as measured by LASCA
Endpoint(s): Baseline bloodflow and area under the curve as measured by LASCA, Cutaneous vascular conductance (CVC), Serum ketone levels in mmol/L, EQ5D-5L questionnaire score

Source: https://euclinicaltrials.eu/ctis-public/view/2022-501682-45-00